EU clinical trial 2024-516994-59-00: A Phase 2a, Open-label, Single-Arm Study Investigating Tolerability of IV/IM Administration of RetinolX (retinol palmitate) in Preterm Infants, and Measuring Serum Levels of Retinol, Retinol Palmitate and Retinol Binding Protein (RBP4) (PARELETO - Trial)
Protocol code: ASP-RET-CT001
Sponsor: Aspire Pharma Limited (Pharmaceutical company). Phase: Therapeutic exploratory (Phase II). Countries: Poland (ongoing, recruitment ended), Germany (ongoing, recruitment ended).
Therapeutic area(s): Diseases [C] - Respiratory Tract Diseases [C08]
Gender: Female, Male. Age: 0-17 years. Enrolment: 20.
Status: Ongoing, recruitment ended. Start date (EU): 2026-02-13. Decision date: 2025-04-09. Results received: No. Last updated: 2026-03-25.
Decision dates by country: PL: 2025-04-14, DE: 2025-04-09

Condition(s): Bronchopulmonary Dysplasia
Product: Retinol

Primary endpoint: Primary Efficacy: Relative increase in serum retinol levels at Day 28 compared to baseline, Safety: Incidence of Treatment Emergent Adverse Events (TEAEs) and Adverse Event of Specific Interest (AESI) throughout the study., Safety: Occurrence of clinically significant changes in laboratory data, physical examination results, and vital signs values throughout the study.
Endpoint(s): Secondary efficacy: Percentage of subjects with relative increase of 60% in serum retinol levels between Day 0 and Day 28., Secondary efficacy: Relative increase in serum retinol levels at Day 7 and Day 14 compared to baseline., Secondary efficacy: Percentage of subjects with need for respiratory support and/or oxygen at 28 days postnatal age., Secondary efficacy: Percentage of subjects with need for respiratory support and/or oxygen at 36 weeks + 0 day PMA.

Source: https://euclinicaltrials.eu/ctis-public/view/2024-516994-59-00